EU clinical trial 2023-508719-22-00: High versus low dose serratus anterior plane block after minimally invasive valve surgery: a double-blinded randomized controlled trial
Sponsor: Jessa Ziekenhuis (Hospital/Clinic/Other health care facility). Phase: Therapeutic use (Phase IV). Countries: Belgium (authorised, recruitment pending).
Therapeutic area(s): Analytical, Diagnostic and Therapeutic Techniques and Equipment [E] - Therapeutics [E02]
Gender: Female, Male. Age: 18-64 years, 65+ years. Enrolment: 100.
Status: Authorised, recruitment pending. Decision date: 2024-02-12. Results received: No. Last updated: 2024-04-15.
Decision dates by country: BE: 2024-04-15

Condition(s): Serratus anterior plane block after an aortic valve replacement
Product: Marcaine 2,5 mg/ml + 5 microg/ml adrenaline, oplossing voor injectie

Primary endpoint: Cumulative morphine consumption by PCIA at 24 hours after block placement. Information on morphine consumption will extracted from the PCIA-system after 24 hours and analyzed using 4-hour intervals.
Endpoint(s): Opioid consumption will be evaluated at predetermined time intervals after performing the Serratus anterior plane block (0-4h, 4-8h, 8-12h, 12-16h, 16-20h, and 20-24h), Number of patients that do not require any additional PCIA opioids within the first 24 hours after block placement., The postoperative pain on the surgical site is evaluated based on a 11-points numeric scale (Numerical Rating Sale - NRS) where 0 = no pain and 10 = worst pain ever. The NRS pain score in rest as well as with deep respiration is assessed at 4 hours, 8 hours, 12 hours and 24 hours after performing the Serratus Anterion Plane Block and at POD 7., Overall patient satisfaction with analgesic therapy will be assessed with an 11-point NRS scale (where 0 = not satisfied at all and 10 = extremely satisfied) 24h after performing the Serratus Anterior Plane Block at POD 1., Time from arrival to the ICU until extubation in minutes., Time from arrival to the ICU until first mobilization. According to our ERACS protocol, active patient mobilization is intended at six hours after surgery on the conditions that patients are extubated, chest tube drainage is low (<50ml/h) and patients are comfortable., The simplified PONV impact scale will be used to assess PONV 24h after performing the SAP block at POD 1. Clinically important PONV will be defined as a score of 5 or more., Time to first defecation (postoperative days) or need for laxatives during hospital stay (number of patients), Time from arrival to the ICU until meeting discharge criteria to the ward in postoperative hours., Time to discharge out of the hospital in postoperative days (day of surgery = day 0), Pneumonia defined as empirical antibiotic therapy for suspicion of pneumonia during hospital stay, in number of patients., Serum bupivacaine levels have never been recorded after SAPB. In the first 36 study patients, arterial blood samples will be taken at 30minutes as well as at 1, 2, 4 and 8 hours after block placement for dosage of total and free plasma bupivacaine levels., Quality of recovery will be assessed at POD 2 and POD 7 with Quality of Life questionnaires: EQ5D and short form health survey (SF-36).

Source: https://euclinicaltrials.eu/ctis-public/view/2023-508719-22-00